EU clinical trial 2023-506435-15-00: A study to assess how radium-223 moves through the patients with prostate cancer receiving radium-223 dichloride treatment.
Protocol code: 20511
Sponsor: Bayer Consumer Care AG, Bayer AG (Pharmaceutical company). Phase: Human Pharmacology (Phase I)- Other. Countries: Austria (ended), Italy (ended), Lithuania (ended), France (ended).
Therapeutic area(s): Diseases [C] - Neoplasms [C04]
Gender: Male. Age: 18-64 years, 65+ years. Enrolment: 51.
Status: Ended. Start date (EU): 2020-08-25. End date (EU): 2024-07-09. End date: 2025-08-06. Decision date: 2024-02-21. Results received: No. Last updated: 2025-04-22.
Decision dates by country: AT: 2024-02-26, FR: 2024-02-26, IT: 2024-03-18, LT: 2024-02-21

Condition(s): Prostate cancer

Source: https://euclinicaltrials.eu/ctis-public/view/2023-506435-15-00